EU clinical trial 2025-524375-23-00: OV-PRIME-R (Oncolytic Virotherapy to enhance PReoperative IMmunotherapy Efficacy in patients with proficient mismatch repair (pMMR) Rectal cancer
Sponsor: Region Hovedstaden (Hospital/Clinic/Other health care facility). Phase: Human Pharmacology (Phase I)- Other. Countries: Denmark (authorised, recruitment pending).
Therapeutic area(s): Diseases [C] - Digestive System Diseases [C06]; Diseases [C] - Neoplasms [C04]
Gender: Female, Male. Age: 18-64 years, 65+ years. Enrolment: 20.
Status: Authorised, recruitment pending. Decision date: 2026-02-23. Results received: No. Last updated: 2026-05-28.

Condition(s): Rectal cancer with proficient mismatch repair (pMMR)

Source: https://euclinicaltrials.eu/ctis-public/view/2025-524375-23-00